EU clinical trial 2023-506946-21-00: Single Rising Dose Study of MK-1708 in Healthy Participants
Protocol code: MK-1708-001
Sponsor: Merck Sharp & Dohme LLC (Pharmaceutical company). Phase: Human Pharmacology (Phase I)- First administration to humans. Countries: Belgium (ended).
Therapeutic area(s): Diseases [C] - Nervous System Diseases [C10]
Gender: Male. Age: 18-64 years. Enrolment: 24.
Status: Ended. Start date (EU): 2023-10-24. End date (EU): 2024-08-01. End date: 2024-08-02. Decision date: 2023-10-13. Results received: No. Last updated: 2024-05-08.

Condition(s): Amyotrophic lateral sclerosis and Alzheimer’s disease

Source: https://euclinicaltrials.eu/ctis-public/view/2023-506946-21-00